EU clinical trial 2022-501085-21-00: A Phase 3, Multicenter, Double-blind, Randomized, Placebo-controlled Clinical Study to Evaluate the Safety and Efficacy of Ertugliflozin (MK-8835/PF-04971729) in Pediatric Participants (ages 10 to 17 years, inclusive) with Type 2 Diabetes Mellitus (MK-8835-059/B1521066)
Protocol code: MK-8835-059
Sponsor: Merck Sharp & Dohme LLC (Pharmaceutical company). Phase: Therapeutic confirmatory (Phase III). Countries: Poland (ended), Italy (ended), Hungary (ended).
Therapeutic area(s): Diseases [C] - Nutritional and Metabolic Diseases [C18]
Gender: Female, Male. Age: 0-17 years. Enrolment: 20.
Status: Ended. Start date (EU): 2019-11-29. End date (EU): 2024-11-19. End date: 2025-04-28. Decision date: 2022-11-24. Results received: Yes. Last updated: 2024-09-09.
Decision dates by country: PL: 2022-11-29, IT: 2022-11-24, HU: 2022-11-28

Condition(s): Type 2 Diabetes Mellitus
Product: Placebo to Ertugliflozin film coated tablets 5mg, ertugliflozin, Placebo to ertugliflozin film coated tablets 15mg, ertugliflozin

Primary endpoint: Change from Baseline in Hemoglobin A1C (HbA1C) at 24 weeks (pooled ertugliflozin 5 mg and 15 mg versus placebo), Number of Participants Who Experience an Adverse Event (AE) over 24 weeks, Number of Participants Who Experience an AE over 54 weeks, Number of Participants Who Discontinue Study Treatment Due to an AE over 24 weeks, Number of Participants Who Discontinue Study Treatment Due to an AE over 54 weeks
Endpoint(s): Change from Baseline in Hemoglobin A1C at Week 24 (dose-optimized ertugliflozin versus placebo), Change from Baseline in Hemoglobin A1C at Week 24 (ertugliflozin 5 mg versus placebo), Change from Baseline in Fasting Plasma Glucose (FPG) at 24 weeks, Change from Baseline in Hemoglobin A1C at 54 weeks, Change from Baseline in FPG at 54 weeks

Source: https://euclinicaltrials.eu/ctis-public/view/2022-501085-21-00